EU clinical trial 2023-510318-25-00: A study in healthy men to test how well different doses of BI 3731579 are tolerated
Protocol code: 1519-0001
Sponsor: Boehringer Ingelheim International GmbH (Pharmaceutical company). Phase: Human Pharmacology (Phase I)- First administration to humans. Countries: Germany (ended).
Therapeutic area(s): Not possible to specify
Gender: Male. Age: 18-64 years. Enrolment: 64.
Status: Ended. Start date (EU): 2024-06-26. End date (EU): 2025-05-27. Decision date: 2024-05-16. Results received: No. Last updated: 2025-03-24.

Condition(s): Healthy volunteer trial

Source: https://euclinicaltrials.eu/ctis-public/view/2023-510318-25-00